EU clinical trial 2024-512879-13-00: A Phase 3, Multicentre, Double-masked, Randomised Study to Evaluate the Efficacy and Safety of Intravitreal OPT-302 in Combination with Ranibizumab, Compared with Ranibizumab Alone, in Participants with Neovascular Age-related Macular Degeneration (nAMD)
Protocol code: OPT-302-1004
Sponsor: Opthea Limited (Pharmaceutical company). Phase: Therapeutic confirmatory (Phase III). Countries: Hungary (ended), Denmark (ended), Czechia (ended), Poland (ended), Latvia (ended), Germany (ended), Spain (ended), France (ended), Italy (ended), Greece (ended).
Therapeutic area(s): Diseases [C] - Eye Diseases [C11]
Gender: Female, Male. Age: 18-64 years, 65+ years. Enrolment: 298.
Status: Ended. Start date (EU): 2021-09-23. End date (EU): 2025-03-31. Decision date: 2024-09-06. Results received: Yes. Last updated: 2025-04-23.
Decision dates by country: CZ: 2024-09-09, DK: 2024-09-10, DE: 2024-09-09, GR: 2024-11-20, HU: 2024-09-09, LV: 2024-09-09, ES: 2024-09-09, PL: 2024-09-06, IT: 2024-09-16, FR: 2024-09-10

Condition(s): Neovascular age-related macular degeneration (wet AMD)
Product: Lucentis 10 mg/ml solution for injection in pre-filled syringe, Lucentis 10 mg/ml solution for injection in pre-filled syringe, Lucentis 10 mg/ml solution for injection in pre-filled syringe, OPT-302, Lucentis 10 mg/ml solution for injection in pre-filled syringe

Primary endpoint: Mean change from Baseline to Week 52 in ETDRS BCVA letters
Endpoint(s): Efficacy: - Proportion of participants gaining 15 or more ETDRS BCVA letters from Baseline to Week 52 - Proportion of participants gaining 10 or more ETDRS BCVA letters from Baseline to Week 52, - Change in CNV area by fluorescein angiography (FA) from Baseline to Week 52 - Proportion of participants with absence of both SRF and IR cysts by spectral domain optical coherence tomography (SD-OCT) at Week 52

Source: https://euclinicaltrials.eu/ctis-public/view/2024-512879-13-00